EU clinical trial 2026-526122-41-00: COLOVERT – Conversion therapy in colorectal cancer with peritoneal metastases not amenable to upfront cytoreductive surgery and HIPEC: a phase II “pick-the-winner” open-label randomized trial
Sponsor: Uppsala University Hospital (Hospital/Clinic/Other health care facility). Phase: Therapeutic exploratory (Phase II). Countries: Sweden (authorised, recruitment pending).
Therapeutic area(s): Not possible to specify
Gender: Female, Male. Age: 18-64 years, 65+ years. Enrolment: 60.
Status: Authorised, recruitment pending. Decision date: 2026-07-15. Results received: No. Last updated: 2026-07-15.

Condition(s): Colorectal cancer with peritoneal metastases
Product: Cisplatin Accord 1 mg/ml koncentrat till infusionsvätska, lösning, Paclitaxel Actavis 6 mg/ml koncentrat till infusionsvätska, lösning., Docetaxel Ebewe 10 mg/ml koncentrat till infusionsvätska, lösning, Gemcitabin Sandoz 40 mg/ml koncentrat till infusionsvätska, lösning, Oxaliplatin Accord 5 mg/ml koncentrat till infusionsvätska, lösning, Doxorubicin Accord 2 mg/ml koncentrat till infusionsvätska, lösning, Mitomycin Substipharm 20 mg, pulver till injektions-/infusionsvätska, lösning eller för intravesikal användning, Irinotecan Accord 20 mg/ml koncentrat till infusionsvätska, lösning

Primary endpoint: Objective response rates according to radiological PCI after 3 cycles of treatment.
Endpoint(s): • Conversion rate to CRS+HIPEC as determined at the second MDT. • Safety as defined by AER from date of randomization until 3 weeks after last treatment cycle. • Overall survival during 3.5 year follow-up • Progression-free survival defined as documented disease progression or death from any cause during 3.5 year follow-up • Patient-derived scaffolding and FMCA analysis will evaluate chemotherapy sensitivity and its predictive value for response rates.

Source: https://euclinicaltrials.eu/ctis-public/view/2026-526122-41-00